EU clinical trial 2023-509678-52-00: A Phase IB/IIA, Randomized, Double-Blind, Placebo-Controlled, Multiple-Ascending Dose, Parallel-Group Study to Investigate the Safety, Tolerability, Pharmacokinetics, and Pharmacodynamics of RO7126209 following Intravenous Infusion in Patients with Prodromal or Mild To Moderate Alzheimer’s Disease
Protocol code: BP42155
Sponsor: F. Hoffmann-La Roche AG (Pharmaceutical company). Phase: Phase I and Phase II (Integrated)- Other. Countries: Spain (ongoing, recruitment ended), Poland (ongoing, recruitment ended).
Therapeutic area(s): Diseases [C] - Nervous System Diseases [C10]
Gender: Female, Male. Age: 18-64 years, 65+ years. Enrolment: 99.
Status: Ongoing, recruitment ended. Start date (EU): 2024-06-27. Decision date: 2024-03-05. Results received: No. Last updated: 2026-07-28.
Decision dates by country: PL: 2024-03-15, ES: 2024-03-05

Condition(s): Alzheimer's disease
Product: Placebo Trontinemab, Trontinemab, Flortaucipir F18

Primary endpoint: 1. Nature, frequency, severity, and timing of AEs, including – for Part 1 only – DLAEs. Significant assessments reported as AEs include clinical laboratory assessments and vital signs, physical and neurological examination, 12-lead ECG, and brain MRI findings (including the occurrence of vasogenic edema and hemorrhage) (Part 1-4), 2. Change from baseline in brain amyloid load, as measured by amyloid PET scan (Part 3)
Endpoint(s): 1. Change from baseline in brain amyloid load, as measured by amyloid PET scan (Part 1, 2 and 4 only), 2. Plasma Concentration of RO7126209 at specified timepoints, 3. CSF concentration of RO7126209, 4. Incidence and titer of anti-RO7126209 ADAs over time

Source: https://euclinicaltrials.eu/ctis-public/view/2023-509678-52-00